EU clinical trial 2022-500902-16-00: A Phase I study to evaluate the safety and dosimetry of 68Ga-labelled OncoFAP derivatives in patients with solid tumors
Protocol code: PH-FAPGA-01/22
Sponsor: Philogen S.p.A. (Pharmaceutical company). Phase: Human Pharmacology (Phase I)- First administration to humans. Countries: Italy (ended).
Therapeutic area(s): Diseases [C] - Neoplasms [C04]
Gender: Female, Male. Age: 18-64 years, 65+ years. Enrolment: 20.
Status: Ended. Start date (EU): 2023-04-27. End date (EU): 2024-04-26. Decision date: 2022-11-09. Results received: No. Last updated: 2024-01-25.

Condition(s): Patients with breast cancer, colorectal cancer, oesophageal cancer and pancreatic adenocarcinoma.

Source: https://euclinicaltrials.eu/ctis-public/view/2022-500902-16-00